EU clinical trial 2024-517155-13-00: A double-blind, placebo-controlled, randomized withdrawal study of canakinumab in pyogenic sterile arthritis pyoderma gangrenosum and acne (PAPA) syndrome
Protocol code: PAPA-Can
Sponsor: IRCCS Istituto Giannina Gaslini (Hospital/Clinic/Other health care facility). Phase: Therapeutic confirmatory (Phase III). Countries: Italy (ongoing, recruitment ended).
Therapeutic area(s): Diseases [C] - Immune System Diseases [C20]
Gender: Female, Male. Age: 0-17 years, 18-64 years, 65+ years. Enrolment: 24.
Status: Ongoing, recruitment ended. Start date (EU): 2024-02-02. Decision date: 2024-11-19. Results received: No. Last updated: 2024-11-19.

Condition(s): PAPA syndrome
Product: Placebo is solution for injection (150 mg/ml) contained in vials equal to those of Canakinumab and appears identical to the Test product. Placebo is provided by Novartis pharma., Ilaris 150 mg/ml solution for injection

Primary endpoint: To determine whether canakinumab administered every 4 weeks is able to prevent disease flares when compared to placebo in canakinumab-responder patients.

Source: https://euclinicaltrials.eu/ctis-public/view/2024-517155-13-00